EU clinical trial 2023-510553-41-00: TAZEMETOSTAT ROLLOVER STUDY (TRUST): AN OPEN-LABEL, ROLLOVER STUDY
Protocol code: EZH-501
Sponsor: Epizyme Inc. (Pharmaceutical company). Phase: Phase I and Phase II (Integrated)- Other. Countries: France (ended), Poland (ended).
Therapeutic area(s): Diseases [C] - Neoplasms [C04]
Gender: Female, Male. Age: 0-17 years, 18-64 years, 65+ years. Enrolment: 40.
Status: Ended. Start date (EU): 2016-08-29. End date (EU): 2025-09-26. Decision date: 2024-05-22. Results received: Yes. Last updated: 2025-08-26.
Decision dates by country: FR: 2024-05-27, PL: 2024-05-22

Condition(s): Subjects will receive tazemetostat as dictated in their antecedent study.

Primary endpoint: Number of subjects with adverse events related to study drug, as a measure of safety and tolerability of tazemetostat, Number of subjects with adverse events, as a measure of safety and tolerability of tazemetostat, Extent of exposure to tazemetostat
Endpoint(s): The OS of subjects receiving tazemetostat, defined as the interval of time between the date of the first dose of tazemetostat and the date of death due to any cause

Source: https://euclinicaltrials.eu/ctis-public/view/2023-510553-41-00